EU clinical trial 2024-519983-42-00: Safety of Rifampicin at High Dose for the Treatment of Adult Subjects with Complex Drug Susceptible Pulmonary and Extrapulmonary Tuberculosis
Protocol code: RIAlta
Sponsor: Fundacio Hospital Universitari Vall D’Hebron Institut De Recerca (Laboratory/Research/Testing facility). Phase: Therapeutic exploratory (Phase II). Countries: Netherlands (ongoing, recruiting), Spain (ongoing, recruiting).
Therapeutic area(s): Diseases [C] - Bacterial Infections and Mycoses [C01]
Gender: Female, Male. Age: 18-64 years, 65+ years. Enrolment: 50.
Status: Ongoing, recruiting. Start date (EU): 2025-02-04. Decision date: 2025-02-04. Results received: No. Last updated: 2025-02-04.
Decision dates by country: ES: 2025-02-04, NL: 2025-02-04

Condition(s): TUBERCULOSIS
Product: Rifampicin 150 mg Capsules, RIMSTAR®, COMPRIMIDOS RECUBIERTOS CON PELÍCULA, Rifampicin 300 mg Capsules

Primary endpoint: proportion of participants with one or more SAE (i.e. grade 3 or 4 AE) at 8 weeks of treatment
Endpoint(s): Eficaccy: The proportion of participants with a favorable outcome at 8 weeks of treatment, Tolerability: proportion of participants having one or more AE in the prospective cohort., efficacy: time to sputum culture conversion from positive to negative, Correlation of the AUC/MIC values with time to sputum culture conversion adjusted with other explanatory covariates, changes in quality of life questionnaires and in TB associated costs from all sites will be depicted

Source: https://euclinicaltrials.eu/ctis-public/view/2024-519983-42-00